EU clinical trial 2023-503295-25-00: A phase II/III randomized clinical trial of CisPlatin plUs Gemcitabine and Nabpaclitaxel (GAP) as pReoperative chemotherapy versus immediate resection in patIents with resecTable BiliarY Tract Cancers (BTC) at high risk for recurrence: PURITY Study.
Protocol code: PURITY
Sponsor: Fondazione GONO G.I. (Patient organisation/association). Phase: Phase II and Phase III (Integrated). Countries: Italy (ongoing, recruiting).
Therapeutic area(s): Diseases [C] - Neoplasms [C04]
Gender: Female, Male. Age: 18-64 years, 65+ years. Enrolment: 108.
Status: Ongoing, recruiting. Start date (EU): 2023-10-31. Decision date: 2023-06-16. Results received: No. Last updated: 2026-06-03.

Condition(s): Resectable biliary tract cancers
Product: GEMCITABINE HYDROCHLORIDE, CISPLATIN, PACLITAXEL ALBUMIN-BOUND, CAPECITABINE

Primary endpoint: The primary endpoint of the phase II part is the 12-month progression-free survival (PFS) rate: the proportion of patients alive and free from progression/post-resection recurrence by 12-months timepoint from randomization (to be considered as primary endpoint in the phase II part of the study and as secondary endpoint in the phase III part of the study).
Endpoint(s): Progression-free survival (PFS), the time from randomization to disease progression, post-resection recurrence or death from any cause, Event free survival (EFS): the time from randomization to disease progression that precludes definitive surgery, treatment discontinuation for any reason, post-resection recurrence, a second primary cancer, or death from any cause., Relapse-free survival (RFS): the time from surgery to disease recurrence or death in patients who undergo to surgery with curative intent., Overall survival (OS): the time from randomization to the date of death due to any cause. For patients still alive at the time of analysis, the OS time will be censored on the last date the patients were known to be alive., R0 Resection Rate: the percentage of patients, relative to the total of randomized patients, for whom a R0 resection is achieved., R0+R1 resection rate, i.e. the percentage of patients, relative to the total of randomized patients, for whom the tumor was macroscopically removed and the intent of surgery is considered curative. Note: R0 surgery is defined as microscopically margin free complete surgical removal of all residual disease. R1 resection indicates the removal of all macroscopic disease, but microscopic margins are positive for tumor., Quality of life (QLQ): assessed through Patient Reported Outcome instruments (PROs) distributed by the study staff and completed entirely by the patient. Mean score changes from baseline, proportion of patients with improved, stable, or deteriorated scores from baseline and time to deterioration in the EORTC QLQ-C30 and BIL21 physical functioning, social functioning, and fatigue scores will be compared between the two arms., Overall Response Rate (ORR): is defined as the percentage of patients, relative to the total of enrolled subjects receiving neoadjuvant treatment, achieving a complete (CR) or partial (PR) response, according to RECIST 1.1 criteria. The determination of clinical response will be based on investigator assessment (during study treatment) and it will be retrospectively evaluated as per blinded independent central review (BICR) of CT scan images., Resectability Rate: the retrospective evaluation of patients with unresectable disease, as assessed by the central review committee, in the two arms, and of the rate of conversion to resectability in the neoadjuvant arm., Toxicity Rate is defined as the percentage of patients, relative to the total of subjects randomized to receive neoadjuvant treatment, experiencing a specific adverse event, according to National Cancer Institute Common Toxicity Criteria, Perioperative morbidity and mortality rate is defined as the percentage of patients, with any serious perioperative morbidity or mortality according to Clavien-Dindo classification

Source: https://euclinicaltrials.eu/ctis-public/view/2023-503295-25-00